EU clinical trial 2024-513250-30-00: TRANSADO - Evaluation of the effectiveness of hormonal treatment in adolescents suffering from gender dysphoria
Protocol code: P170923J
Sponsor: Assistance Publique Hopitaux De Paris (Hospital/Clinic/Other health care facility). Phase: Therapeutic confirmatory (Phase III). Countries: France (ongoing, recruiting).
Therapeutic area(s): Psychiatry and Psychology [F] - Behavior and Behavior Mechanisms [F01]
Gender: Female, Male. Age: 0-17 years. Enrolment: 60.
Status: Ongoing, recruiting. Start date (EU): 2024-06-25. Decision date: 2024-09-16. Results received: No. Last updated: 2026-07-21.

Condition(s): gender dysphoria
Product: PROVAMES 1 mg, comprimé pelliculé, ANDROGEL 16,2 mg/g, gel, ESTREVA 0,1 %, gel

Primary endpoint: The primary outcome measure is the adolescent's global functioning as assessed by the Children's Global Assessment Scale (CGAS) at age 16 years old +/- 6 months.
Endpoint(s): - Global Assesment Scale (GAS) at T2., - Weschler scale (WISC V) at T0 et T2,, - The Gender Identity/ Gender Dysphoria Questionnaire for Adolescents and Adults scale (GIDYQ-AA) and the Utrecht Gender Dysphoria Scale (UGDS) at selection visit, T1 et T2,, - Beck Depression Inventory (BDI) scale at screening, T1 et T2,, - Body Image Scale (BIS) scale at T0, T1 et T2,, - State-Trait Anxiety Inventory for Children (STAIC) scale at T0, T1 et T2,, - Child Behaviour Checklist (CBCL) scale at T0, T1 et T2,, - MINI International Neuropsychiatric Interview (MINI) at selection visit, T1 et T2, - Youth Self Report (YSR) scale at T0, T1 et T2,, - World Health Organization Quality Of Life - BREF (WHOQOL-BREF) scale at T0, T1 et T2,, - Satisfaction With Life Scale (SWLS) at T0, T1 et T2., - Height, bone mineral density, BMI, waist to hip ratio at inclusion visit, T1 et T2., - Potential side-effects at T0, T1 et T2., - The emotional and sexual relationship: assessed by specific questions at T0, T1 et T2, - Drug use: assessed by specific questions via the DEP-ADO questionnaire (screening grid for problem substance use among adolescents) at T0, T1 and T2, - School drop-out / family breakdown: assessed by specific questions at T0, T1 et T2, Psycho-affective criteria will be assessed by a psychologist trained in the relevant assessment scales, while somatic criteria will be collected by the pediatric endocrinologist., - Columbia-Suicide Severity Rating Scale (C-SSRS) score at screening visit, T1 and T2 (in case of suicidal ideation identified through the MINI)

Source: https://euclinicaltrials.eu/ctis-public/view/2024-513250-30-00